EU clinical trial 2023-505405-17-00: A Two Part Phase IIa/b Multicenter, Randomized, Double-Blind, Placebo Controlled, Parallel Group Dose ranging Study to Assess Efficacy, Safety, and Tolerability of the Combination of Zibotentan and Dapagliflozin, and Dapagliflozin Monotherapy Versus Placebo in Participants with Cirrhosis with Features of Portal Hypertension
Protocol code: Zeal
Sponsor: Astrazeneca AB (Pharmaceutical company). Phase: Therapeutic exploratory (Phase II). Countries: Spain (ended), Germany (ended), Netherlands (ended), Denmark (ended), Austria (ended), Belgium (ended), France (ended), Czechia (ended), Romania (ended).
Therapeutic area(s): Diseases [C] - Digestive System Diseases [C06]
Gender: Female, Male. Age: 18-64 years, 65+ years. Enrolment: 111.
Status: Ended. Start date (EU): 2022-10-07. End date (EU): 2025-07-17. End date: 2025-07-18. Decision date: 2023-07-25. Results received: Yes. Last updated: 2025-02-07.
Decision dates by country: CZ: 2024-06-19, RO: 2024-08-26, DK: 2023-07-26, AT: 2023-08-03, BE: 2023-08-29, DE: 2023-07-31, NL: 2023-07-26, ES: 2023-07-25, FR: 2024-05-17

Condition(s): Liver cirrhosis with features of portal hypertension.
Product: Zibotentan, Zibotentan, Zibotentan, Zibotentan Placebo, Dapagliflozin Placebo, DAPAGLIFLOZIN

Primary endpoint: Part A Primary End Point: Absolute change in HVPG from baseline to Week 6., Part B Primary End Point: Absolute change in HVPG from baseline to Week 6
Endpoint(s): Part A: Percent change in HVPG from baseline to Week 6., Part A: HVPG response, where a responder is defined as HVPG < 10 mmHg or a reduction in HVPG of ≥ 1.5 mmHg from baseline to Week 6., Part A: Evaluation of change in body weight (kg) over time course of study (Home-based balance) Percentage and absolute change from baseline in body weight at Week 6. (Office balance), Part A: Percentage and Absolute change in total change dosage of loopdiuretic equivalents use from baseline to Week 6., Part A: Change in total body water, extracellular water and intracellular water volumes from baseline to Week 6. Change in total body fat mass from baseline to Week 6., Part A: Change in systolic and diastolic blood pressure from baseline to Week 6, Part B: Percentage and change in HVPG from baseline to Week 6., Part B: Evaluation of change in body weight (kg) over time course of study. (Home-based balance) Percentage and absolute change from baseline in body weight at Week 6 and Week 16. (Office balance), Part B: Absolute change in total dosage of loop-diuretic equivalents use from baseline to Week 6 and Week 16, Part B: Change in total body water, extracellular water and intracellular water volumes from baseline to Week 6 and Week 16. Change in total body fat mass from baseline to Week 6 and Week 16, Part B: Change in systolic and diastolic blood pressure from baseline to Week 6 and Week 16., Part B : To evaluate Part B: HVPG response, where a responder is defined as at least 20% decrease or a reduction to or below 12 mmHg in HVPG from baseline to Week 6.

Source: https://euclinicaltrials.eu/ctis-public/view/2023-505405-17-00